EU clinical trial 2023-510033-28-00: Randomized, double-blind, placebo-controlled clinical trial to evaluate the optimal dose of Beltavac® with polymerized extract of grass pollen mixture in patients with allergic rhinoconjunctivitis associated or not with asthma.
Protocol code: PRO RCT GRAM 2022
Sponsor: Probelte Pharma S.L. (Pharmaceutical company). Phase: Therapeutic exploratory (Phase II). Countries: Spain (not authorised), Poland (not authorised).
Therapeutic area(s): Diseases [C] - Disorders of Environmental Origin [C21]; Diseases [C] - Eye Diseases [C11]
Gender: Female, Male. Age: 18-64 years. Enrolment: 150.
Status: Not authorised. Decision date: 2024-06-10. Results received: No. Last updated: 2024-06-14.
Decision dates by country: ES: 2024-06-10, PL: 2024-06-14

Condition(s): allergic rhinoconjunctivitis caused due to exposure to pollen grasses
Product: PLACEBO, BELTAVAC polymerized grass mix, BELTAVAC polymerized grass mix

Primary endpoint: Proportion of patients whose reactivity to the Conjunctival Provocation Test (CPT) with grass extract decreases between baseline and visit 7. It means that the titrated 10 – fold step allergen concentration required to develop a positive response is at least one dose higher.
Endpoint(s): Combined nasal and conjunctival symptoms and rescue medication score (CSMS) obtained during the peak pollen season through the Diary patient App. Nasal and conjunctival symptoms score obtained during the peak pollen season through the Diary patient App., Rhinoconjunctivitis daily medication score obtained during the peak pollen season through the Diary patient App.

Source: https://euclinicaltrials.eu/ctis-public/view/2023-510033-28-00